EU clinical trial 2025-522227-99-00: A randomized, placebo-controlled, double-blind Phase 3 study to evaluate the efficacy, safety and tolerability of votoplam in participants with Huntington’s Disease
Protocol code: CHTT227A12301
Sponsor: Novartis Pharma AG (Pharmaceutical company). Phase: Therapeutic confirmatory (Phase III). Countries: Norway (authorised, recruitment pending), Poland (authorised, recruitment pending), Spain (authorised, recruitment pending), Sweden (authorised, recruitment pending), Bulgaria (authorised, recruitment pending), Netherlands (authorised, recruitment pending), Finland (authorised, recruitment pending), Portugal (authorised, recruitment pending), Austria (authorised, recruitment pending), Italy (authorised, recruitment pending), Greece (authorised, recruitment pending), Ireland (authorised, recruitment pending), Czechia (authorised, recruitment pending), France (ongoing, recruiting), Romania (authorised, recruitment pending), Belgium (authorised, recruitment pending), Germany (authorised, recruitment pending), Denmark (authorised, recruitment pending), Slovakia (authorised, recruitment pending), Hungary (authorised, recruitment pending).
Therapeutic area(s): Diseases [C] - Nervous System Diseases [C10]
Gender: Female, Male. Age: 18-64 years, 65+ years. Enrolment: 368.
Start date (EU): 2026-07-28. Decision date: 2026-07-20. Results received: No. Last updated: 2026-08-07.
Decision dates by country: AT: 2026-07-27, GR: 2026-07-21, BG: 2026-07-27, RO: 2026-07-27, BE: 2026-07-23, DK: 2026-07-20, FR: 2026-07-21, DE: 2026-07-23, HU: 2026-07-24, IT: 2026-07-22, PT: 2026-07-21, ES: 2026-07-22, NL: 2026-07-20, PL: 2026-07-23, SK: 2026-07-20, FI: 2026-07-21, IE: 2026-07-24, SE: 2026-07-22, NO: 2026-07-21, CZ: 2026-07-21

Condition(s): Huntington’s Disease
Product: HTT227, Placebo to 00mg tablet

Primary endpoint: Change from Baseline to Month 36 in cUHDRS score
Endpoint(s): Change from Baseline to Month 36 in UHDRS-TFC, Change from Baseline to Month 36 in UHDRS-IS, The time to decline in TFC score by at least one or IS score by at least 10 over the treatment period, Change from Baseline to month 36 in UHDRS-TMS, Change from Baseline to Month 36 in SDMT, Change from Baseline to Month 36 in SWRT, Percent change from Baseline to steady state in blood mHTT protein, Change from Baseline to Month 36 in serum NfL, Incidence and severity of treatment-emergent adverse events (TEAEs), serious adverse events (SAEs) and TEAEs leading to participant withdrawal

Source: https://euclinicaltrials.eu/ctis-public/view/2025-522227-99-00